EU clinical trial 2023-505845-17-00: Efficacy of the Doravirine/Tenofovir Disoproxil Fumarate/Lamivudine combination in people living with HIV with a history of M184V/I mutation and virologically controlled: a phase II, open-label, non-comparative pilot study.
Protocol code: Drive Off Road
Sponsor: Centre Hospitalier Universitaire De Caen Normandie (Hospital/Clinic/Other health care facility). Phase: Therapeutic exploratory (Phase II). Countries: France (ongoing, recruiting).
Therapeutic area(s): Diseases [C] - Virus Diseases [C02]
Gender: Female, Male. Age: 18-64 years, 65+ years. Enrolment: 32.
Status: Ongoing, recruiting. Start date (EU): 2024-02-08. Decision date: 2023-11-15. Results received: No. Last updated: 2026-02-27.

Condition(s): Patients living with HIV-1 who are virologically controlled and carry an M184V/I mutation in a previous genotype
Product: Delstrigo 100 mg/300 mg/245 mg film-coated tablets

Primary endpoint: Concerning the main analysis, the proportion of patients with an undetectable viral load at 24 weeks will be carried out per-protocol, that is to say that subjects who interrupt the experimental treatment without having reached a classifying event for the main criterion judgment or lost to follow-up will not be considered failures. A sensitivity analysis will be conducted, according to the FDA snapshot algorithm, on an intention-to-treat-exposed (ITT-e) basis.
Endpoint(s): Proportion of patients with an undetectable viral load (<50 copies/ml) at 48 weeks, according to the FDA's intention-to-treat-exposed (ITT-e) snapshot algorithm. The intention-to-treat exposed population includes all patients who received at least one dose of DOR/3TC/TDF., volution of the NGS genotype on proviral DNA between baseline, S24 and S48, Delta CD4 between BL, S24 and S48, Delta weight between BL, S24 and S48, Delta LDL, HDL, Triglycerides and total cholesterol between BL, W24 and W48, Delta QoL SF36 between BL, S24 and S48, HIVTSQc overall score at S12

Source: https://euclinicaltrials.eu/ctis-public/view/2023-505845-17-00